EU clinical trial 2024-513105-31-00: Personalized extended interval dosing of natalizumab in relapsing remitting multiple sclerosis (NEXT-MS)
Sponsor: Amsterdam UMC Stichting (Hospital/Clinic/Other health care facility). Phase: Therapeutic use (Phase IV). Countries: Netherlands (ongoing, recruitment ended).
Therapeutic area(s): Diseases [C] - Nervous System Diseases [C10]
Gender: Female, Male. Age: 18-64 years, 65+ years. Enrolment: 440.
Status: Ongoing, recruitment ended. Start date (EU): 2024-07-30. Decision date: 2024-07-30. Results received: No. Last updated: 2026-01-29.

Condition(s): Multiple Sclerosis
Product: Tysabri 300 mg concentrate for solution for infusion, Tyruko 300 mg concentrate for solution for infusion, Tysabri 150 mg solution for injection in pre-filled syringe

Primary endpoint: Radiological disease activity (new/enlarging T2 lesions on brain MRI) after two years

Source: https://euclinicaltrials.eu/ctis-public/view/2024-513105-31-00